EU clinical trial 2024-514208-15-00: teACH: A Phase 2b, Multicenter, Double-Blind, Randomized, Placebo controlled Trial evaluating Efficacy and Safety of Subcutaneous Doses of Navepegritide Administered Once Weekly for 52 Weeks in Adolescents (12-<18 years of age) with Achondroplasia
Protocol code: ASND0045
Sponsor: Ascendis Pharma Growth Disorders A/S (Pharmaceutical company). Phase: Therapeutic exploratory (Phase II). Countries: Denmark (ongoing, recruiting), France (ongoing, recruiting), Ireland (ongoing, recruiting).
Therapeutic area(s): Diseases [C] - Musculoskeletal Diseases [C05]
Gender: Female, Male. Age: 0-17 years. Enrolment: 20.
Status: Ongoing, recruiting. Start date (EU): 2024-12-10. Decision date: 2024-09-19. Results received: No. Last updated: 2026-06-30.
Decision dates by country: DK: 2024-09-19, FR: 2025-01-15, IE: 2025-02-04

Condition(s): Achondroplasia in Children and Adolescents
Product: TransCon CNP 3.9 mg CNP-38/vial, Placebo for TransCon CNP

Primary endpoint: AGV at Week 52
Endpoint(s): Change from baseline in height Z-score at Week 52

Source: https://euclinicaltrials.eu/ctis-public/view/2024-514208-15-00